EU clinical trial 2022-501831-18-00: A multi-center randomized, double blinded phase IIb trial evaluating oral pooled fecal microbiotherapy MaaT033 to prevent allogeneic hematopoietic cell transplantation complications
Protocol code: MPOH08
Sponsor: Maat Pharma (Pharmaceutical company). Phase: Therapeutic exploratory (Phase II). Countries: Germany (ongoing, recruiting), France (ongoing, recruiting), Belgium (ongoing, recruiting), Spain (ongoing, recruiting), Netherlands (ongoing, recruiting).
Therapeutic area(s): Diseases [C] - Hemic and Lymphatic Diseases [C15]
Gender: Female, Male. Age: 18-64 years, 65+ years. Enrolment: 374.
Status: Ongoing, recruiting. Start date (EU): 2023-09-13. Decision date: 2023-03-03. Results received: No. Last updated: 2026-04-01.
Decision dates by country: BE: 2024-03-04, NL: 2024-02-15, FR: 2023-03-03, ES: 2024-01-30, DE: 2023-03-13

Condition(s): Patients with hematologic malignancies and undergoing allogenic hematopoietic cell transplantation
Product: Placebo is an inert coated capsule with no microbiota (active substance) inside. It is composed of a mix of coloring agents and partially pre-gelatinized corn starch in Hydroxypropyl methylcellulose capsule., MaaT033

Primary endpoint: Parameter: Overall survival (OS). For this endpoint, OS is defined as the time from the date of alloHCT to the date of death from any cause.
Endpoint(s): See table 1 of the protocol for details

Source: https://euclinicaltrials.eu/ctis-public/view/2022-501831-18-00